EU clinical trial 2024-514440-86-00: Response-adaptive to Epcoritamab In FIrst Relapse: A Phase II, response-adaptive, Open-Label, Multicenter Study to Evaluate the Efficacy of Eptoritamab in Patients with Relapse/Refractory Large B Cell Lymphoma
Protocol code: REPIFIR-AGR-GEL-23
Sponsor: Fundacion Geltamo (Patient organisation/association). Phase: Therapeutic exploratory (Phase II). Countries: Spain (ongoing, recruiting).
Therapeutic area(s): Diseases [C] - Hemic and Lymphatic Diseases [C15]
Gender: Female, Male. Age: 18-64 years, 65+ years. Enrolment: 80.
Status: Ongoing, recruiting. Start date (EU): 2025-08-04. Decision date: 2025-05-14. Results received: No. Last updated: 2026-07-08.

Condition(s): Relapse/Refractory Large B Cell Lymphoma
Product: MINJUVI 200 mg powder for concentrate for solution for infusion, Revlimid 25 mg hard capsules, Revlimid 25 mg hard capsules, Revlimid 25 mg hard capsules, Revlimid 25 mg hard capsules, Epcoritamab (GEN3013), Epcoritamab (GEN3013)

Primary endpoint: The efficacy of Epcoritamab monotherapy will be centrally evaluated by the best CRR at any moment since initiation. The CRR will be assessed by PET-CT according to Lugano Classification (Appendix 3) and is defined as the proportion of patients who achieve a best response of complete response (CR) at any moment since initiation of Epcoritamab first administration
Endpoint(s): The efficacy of Epcoritamab monotherapy will be centrally evaluated by the best CRR, defined as the proportion of patients who achieve a best response of CR after 3 cycles of Epcoritamab administration, The efficacy of Epcoritamab monotherapy and combination therapy with tafasitamab-lenalidomide will be evaluated by local investigators and central evaluation as per CRR (locally evaluated for Epcoritamab monotherapy; local and central evaluation for combination therapy), ORR, DoR, DoCR, Event-free survival (EFS), PFS and OS at any time, The efficacy of Epcoritamab monotherapy and combination therapy with tafasitamab-lenalidomide will be evaluated by MRD (positive or negative) from ctDNA samples immediately before initiation of C3, C4, C7, C10, C12, C13, C15, End of Treatment (EoT) and cycles 18/24 (epcoritamab monotherapy) or cycles 21/27 (combination therapy)., The PFS, OS and DoR of patients with negative MRD at Visit 3 (V3) (immediately before administrating C3 of Epcoritamab monotherapy), as previously defined in this section, The safety and tolerability of Epcoritamab monotherapy and combination therapy with tafasitamab-lenalidomide are evaluated as follows: Type, frequency, and severity of adverse events

Source: https://euclinicaltrials.eu/ctis-public/view/2024-514440-86-00